EU clinical trial 2023-503387-16-00: Multiple Part Clinical Trial of Brentuximab Vedotin in Classical Hodgkin Lymphoma Subjects
Protocol code: SGN35-027
Sponsor: Seagen Inc. (Pharmaceutical company). Phase: Therapeutic exploratory (Phase II). Countries: Spain (ended), Czechia (ended), Italy (ended), Poland (ended).
Therapeutic area(s): Diseases [C] - Neoplasms [C04]
Gender: Female, Male. Age: 18-64 years, 65+ years. Enrolment: 22.
Status: Ended. Start date (EU): 2021-07-13. End date (EU): 2024-08-23. End date: 2024-08-24. Decision date: 2023-10-10. Results received: Yes. Last updated: 2024-06-10.
Decision dates by country: IT: 2023-11-14, PL: 2024-01-16, CZ: 2023-10-23, ES: 2023-10-10

Condition(s): Classical Hodgkin Lymphoma
Product: Dacarbazine Lipomed 500 mg powder for solution for infusion, DOXORUBICINE ACCORD 2 mg/ml, solution pour perfusion, ADCETRIS 50 mg powder for concentrate for solution for infusion, OPDIVO 10 mg/mL concentrate for solution for infusion.

Primary endpoint: CR rate at EOT
Endpoint(s): Incidence, severity, seriousness, and relatedness of AEs; incidence and severity of lab abnormalities, Estimate the ORR, DOR, DOCR, EFS, PFS

Source: https://euclinicaltrials.eu/ctis-public/view/2023-503387-16-00